EU clinical trial 2025-522464-32-00: Clinical study to evaluate the safety and tolerability of long-term treatment with Lecicarbon® in patients with chronic constipation
Protocol code: ATS_9711
Sponsor: Athenstaedt GmbH & Co. KG (Pharmaceutical company). Phase: Therapeutic use (Phase IV). Countries: Germany (ongoing, recruiting).
Therapeutic area(s): Diseases [C] - Digestive System Diseases [C06]
Gender: Female, Male. Age: 18-64 years, 65+ years. Enrolment: 100.
Status: Ongoing, recruiting. Start date (EU): 2025-09-09. Decision date: 2025-08-06. Results received: No. Last updated: 2026-07-06.

Condition(s): Treatment of chronic constipation
Product: Lecicarbon® E CO2-Laxans

Primary endpoint: Prospective documentation of tolerability, safety and compliance of Lecicarbon® E CO2 laxative in chronic constipation using the recommended CHMP guideline-specific tool ‘complete spontaneous bowel movements’ (CSBM), documented in patient diaries
Endpoint(s): Prospective documentation of ‘constipation symptoms’ (PAC-SYM) and ‘quality of life’ (PAC-QOL)

Source: https://euclinicaltrials.eu/ctis-public/view/2025-522464-32-00